EU clinical trial 2025-521032-11-00: A Phase 1b/2 Open-label Study Evaluating different MK-6070 and Ifinatamab Deruxtecan (MK-2400)-based regimens in First-line Extensive Stage Small Cell Lung Cancer
Protocol code: MK-6070-003
Sponsor: Merck Sharp & Dohme LLC (Pharmaceutical company). Phase: Phase I and Phase II (Integrated)- Other. Countries: Germany (authorised, recruiting), Poland (authorised, recruiting), Greece (ongoing, recruiting), Italy (ongoing, recruiting), France (authorised, recruitment pending), Spain (ongoing, recruiting).
Therapeutic area(s): Diseases [C] - Neoplasms [C04]
Gender: Female, Male. Age: 18-64 years. Enrolment: 79.
Start date (EU): 2026-06-17. Decision date: 2026-06-08. Results received: No. Last updated: 2026-08-03.
Decision dates by country: ES: 2026-06-11, PL: 2026-06-12, IT: 2026-06-12, GR: 2026-06-10, FR: 2026-06-08, DE: 2026-06-11

Condition(s): Small cell lung cancer extensive stage
Product: ETOPOSIDE, Ifinatamab Deruxtecan, CARBOPLATIN, MK-6070, ATEZOLIZUMAB, TOCILIZUMAB

Primary endpoint: Number of Participants Who Experience an Adverse Event (AE), Number of Participants Who Experience One or More Dose-Limiting Toxicities (DLTs), Number of Participants Who Discontinue Study Intervention Due to an AE, Objective Response Rate (ORR)
Endpoint(s): Disease Control Rate (DCR), Duration of Response (DOR), Progression-Free Survival (PFS), Overall Survival (OS), Area Under the Concentration-Time Curve Over the Dosing Interval t (AUCt) of Gocatamig (MK-6070), AUCt of Ifinatamab Deruxtecan (I-DXd), AUCt of Deruxtecan (DXd), AUCt of Anti-B7-H3 Antibody, Area Under the Steady-State Concentration-Time Curve Over the Dosing Interval t (AUCt,ss) of Gocatamig, AUCt,ss of I-DXd, AUCt,ss of DXd, AUCt,ss of Anti-B7-H3 Antibody, Maximum Concentration (Cmax) of Gocatamig, Cmax of I-DXd, Cmax of DXd, Cmax of Anti-B7-H3 Antibody, Trough Concentration (Ctrough) of Gocatamig, Ctrough of I-DXd, Ctrough of DXd, Ctrough of Anti-B7-H3 Antibody, Incidence of Anti-Drug Antibodies (ADAs) Against Gocatamig, Incidence of ADAs Against I-DXd

Source: https://euclinicaltrials.eu/ctis-public/view/2025-521032-11-00